EU clinical trial 2024-517676-37-01: Daratumumab in Monoclonal Gammopathy of Renal Significance in Finland, DAMOCLES
Protocol code: MGRS 1.8
Sponsor: HUS-Yhtymae (Hospital/Clinic/Other health care facility). Phase: Human Pharmacology (Phase I)- Other. Countries: Finland (ongoing, recruiting).
Therapeutic area(s): Diseases [C] - Neoplasms [C04]
Gender: Female, Male. Age: 18-64 years, 65+ years. Enrolment: 30.
Status: Ongoing, recruiting. Start date (EU): 2025-06-01. Decision date: 2025-01-29. Results received: No. Last updated: 2026-04-29.

Condition(s): Monoclonal Gammopathy of Renal Significance (MGRS)

Source: https://euclinicaltrials.eu/ctis-public/view/2024-517676-37-01